EU clinical trial 2024-513121-22-00: A Phase 2 Study of Novel Combination Therapies in Participants With Previously Untreated Recurrent or Metastatic Head and Neck Squamous Cell Carcinoma Regardless of PD-L1 Expression Status
Protocol code: GS-US-699-7184-01
Sponsor: Gilead Sciences Inc. (Pharmaceutical company). Phase: Therapeutic exploratory (Phase II). Countries: Italy (ended), Spain (ended), France (ended).
Therapeutic area(s): Diseases [C] - Neoplasms [C04]
Gender: Female, Male. Age: 18-64 years, 65+ years. Enrolment: 21.
Status: Ended. Start date (EU): 2025-02-04. End date (EU): 2026-02-17. Decision date: 2024-12-16. Results received: No. Last updated: 2026-02-26.
Decision dates by country: ES: 2024-12-16, FR: 2024-12-31, IT: 2024-12-30

Condition(s): Recurrent or Metastatic Head and Neck Squamous Cell Carcinoma
Product: Carboplatin 10 mg/ml Concentrate for Solution for Infusion, DOMVANALIMAB, Paclitaxel 6 mg/ml concentrate for solution for infusion, Zimberelimab

Primary endpoint: Objective response rate (ORR), defined as the proportion of participants who achieve a complete response (CR) or partial response (PR) as measured by Response Evaluation Criteria in Solid Tumors (RECIST) v1.1 using investigator assessments [Time Frame: Up to 36 months], Progression-free survival (PFS), defined as the time from the date of randomization until the first date of documented progressive disease (PD) or death from any cause, whichever occurs first, as measured by RECIST v1.1 using investigator assessments [Time Frame: Up to 36 months]
Endpoint(s): DOR, defined as the time from the date of the first documented response until the first date of documented PD or death from any cause, whichever occurs first, as measured by RECIST v1.1 using investigator assessments. [Time Frame: Up to 36 months], PFS6, defined as the proportion of participants alive and PD-free from date of randomization until 6 months as measured by RECIST v1.1 using investigator assessments. [Time Frame: Up to 36 months], OS, defined as the time from the date of randomization until the date of death from any cause. [Time Frame: Up to 36 months], OS6 and OS12, defined as the proportion of participants alive at 6 months and 12 months from the date of randomization, respectively. [Time Frame: Up to 36 months], DCR, defined as the proportion of participants who achieve a CR, PR, or stable disease (SD) as measured by RECIST v1.1 using investigator assessments. [Time Frame: Up to 36 months], TTP, defined as the time from randomization until the first date of documented PD as measured by RECIST v1.1 using investigator assessments. [Time Frame: Up to 36 months], Percentage of Participants Experiencing Treatment-emergent Adverse Events (TEAEs) and Related TEAEs. [Time Frame: First dose date up to 24 months plus 100 days], Percentage of Participants Experiencing Clinical Laboratory Abnormalities. [Time Frame: First dose date up to 24 months plus 100 days]

Source: https://euclinicaltrials.eu/ctis-public/view/2024-513121-22-00